EU clinical trial 2024-516357-46-00: A study to evaluate the safety and efficacy of the tumor-targeting human antibody-cytokine fusion protein L19TNF plus standard temozolomide chemoradiotherapy in patients with newly diagnosed glioblastoma.
Protocol code: PH-L19TNFTMZ-01/20
Sponsor: Philogen S.p.A. (Pharmaceutical company). Phase: Phase I and Phase II (Integrated)- Other. Countries: Germany (authorised, recruitment pending), Italy (authorised, recruitment pending).
Therapeutic area(s): Diseases [C] - Neoplasms [C04]
Gender: Female, Male. Age: 18-64 years, 65+ years. Enrolment: 70.
Status: Authorised, recruitment pending. Decision date: 2025-03-11. Results received: No. Last updated: 2026-07-23.
Decision dates by country: DE: 2025-03-11, IT: 2025-03-14

Condition(s): Glioblastoma
Product: Fibromun, Temozolomide SUN 100 mg hard capsules

Primary endpoint: Primary endpoints for Phase I The following primary endpoints will be considered: − Occurrence of dose limiting toxicity (DLT) assessed by frequency and grade of adverse events (AE) according to CTCAE v.5.0., Primary endpoints for Phase IIb The following primary endpoint will be considered: − Overall survival (OS)
Endpoint(s): Phase I. safety:− Assessment of the formation of human anti-fusion protein antibodies (HAFA) against L19TNF. − Pharmacokinetic characterization of L19TNF. Efficacy: − Progression-free survival (PFS) based on iRANO criteria. − Overall survival (OS) rate at 12 months (52 weeks). − Overall survival (OS). − Objective response rate (ORR) based on iRANO criteria., Phase IIb:−PFS based on RANO 2.0 criteria and on standardized MRI protocol.−OS rate at 12 months −ORR, consisting of CR and PR −DCR −DoR −HRQol − Incidence and grade of AEs, TRAEs, SAE, DILI and abnormal findings in standard laboratory assessments, ECG, ECHO and physical examination according to CTCA v.5.0 −Incidence of dose reductions, cumulative dose and duration of treatment of L19TNF, TMZ and RT -Assessment of HAFA against L19TNF.− Pharmacokinetic characterization of L19TNF.

Source: https://euclinicaltrials.eu/ctis-public/view/2024-516357-46-00